EU clinical trial 2024-511413-37-00: Local Antibiotic Delivery for Community Acquired Pneumonia - Pilot study (LANDCAP1)
Sponsor: Gentofte Hospital (Hospital/Clinic/Other health care facility). Phase: Therapeutic exploratory (Phase II). Countries: Denmark (ongoing, recruiting).
Therapeutic area(s): Diseases [C] - Respiratory Tract Diseases [C08]; Diseases [C] - Bacterial Infections and Mycoses [C01]
Gender: Female, Male. Age: 18-64 years, 65+ years. Enrolment: 36.
Status: Ongoing, recruiting. Start date (EU): 2025-03-03. Decision date: 2024-06-18. Results received: No. Last updated: 2025-10-01.

Condition(s): Community-acquired pneumonia
Product: Quinsair 240 mg nebuliser solution, SODIUM CHLORIDE

Primary endpoint: Proportion of patients with a drop in FEV1 of 20% or 300mL one hour following the first inhalation.
Endpoint(s): Proportion of patients with a drop in FEV1 of 20% or 300mL from baseline to day 4 or discharge, whichever comes first., CRP on day 4 higher than on any day from 1 to 3 including baseline., MAP ≤ 65 OR respiratory frequency > 25 OR pulse > 100 OR needing supplemental oxygen (1-4 of these fulfilled) on day 4., PCT on day 4 higher than baseline., Temperature ≥ 38.0 °C on day 4., Patient reported outcome measurements: Changes in Visual Analogue Scales for dyspnoea, cough and fatigue from baseline to day 4.

Source: https://euclinicaltrials.eu/ctis-public/view/2024-511413-37-00